EU clinical trial 2025-522432-14-00: A study in healthy people to test whether BI 764198 influences the amount of metformin in the body
Protocol code: 1434-0005
Sponsor: Boehringer Ingelheim International GmbH (Pharmaceutical company). Phase: Human Pharmacology (Phase I)- Other. Countries: Germany (ended).
Therapeutic area(s): Not possible to specify
Gender: Female, Male. Age: 18-64 years. Enrolment: 14.
Status: Ended. Start date (EU): 2026-02-03. End date (EU): 2026-03-17. Decision date: 2025-11-05. Results received: No. Last updated: 2025-12-18.

Condition(s): Healthy volunteer trial

Source: https://euclinicaltrials.eu/ctis-public/view/2025-522432-14-00